EU clinical trial 2024-517658-90-00: ProspectivE phase 0 pilot study, assessing potential prognostic and theranostic interest of 68Ga-PentiXafor PET-CT In metastatic triple neGative brEast caNCer patiEnts (EXIGENCE)
Protocol code: ICO-2023-17
Sponsor: Institut De Cancerologie De L Ouest (Hospital/Clinic/Other health care facility). Phase: Human Pharmacology (Phase I)- Other. Countries: France (ongoing, recruiting).
Therapeutic area(s): Diseases [C] - Neoplasms [C04]
Gender: Female, Male. Age: 18-64 years, 65+ years. Enrolment: 12.
Status: Ongoing, recruiting. Start date (EU): 2025-12-01. Decision date: 2025-03-24. Results received: No. Last updated: 2026-04-22.

Condition(s): triple-negative breast cancer
Product: [68Ga]Ga-PentixaFor

Primary endpoint: Concordance study of metastatic uptake seen in [18F]FDG PET/CT scan and [68Ga]Ga-PentixaFor PET/CT scan per "lesion" by comparing for each lesion the [18F]FDG PET scan and [68Ga]Ga-PentixaFor PET/CT scan by assessing a ratio "Number of positive or negative [68Ga]Ga-PentixaFor lesions / Number of positive or negative FDG lesions” performed at patient inclusion.
Endpoint(s): a) Concordance study of metastatic uptake seen in [18F]FDG PET/CT scan and [68Ga]Ga-PentixaFor PET/CT scan per "lesion" by comparing for each lesion the [18F]FDG PET/CT scan and [68Ga]Ga-PentixaFor PET/CT scan by assessing a ratio "Number of positive or negative [68Ga]Ga-PentixaFor lesions / Number of positive or negative FDG lesions” performed at imaging evaluation performed within 3 to 9 months after first [68Ga]Ga-PentixaFor PET/CT. ., b) Conventional imaging (CT scan), and [68Ga]Ga-PentixaFor PET/CT will be analysed for each lesion, obtaining a ratio of number of [68Ga]Ga-PentixaFor(+) lesions / number of CT scan lesions" at patient inclusion., c) Conventional imaging: CT scan, and [68Ga]Ga-PentixaFor PET/CT will be analysed for each lesion, obtaining a ratio of number of [68Ga]Ga-PentixaFor(+) lesions / number of CT scan lesions" at imaging evaluation performed within 3 to 9 months after first [68Ga]Ga-PentixaFor PET/CT, d) Percentage of [68Ga]Ga-PentixaFor(+) metastatic tumor burden compared to total metastatic tumor burden by [18F]FDG PET/CT ., e) Assess the correlation between the standard uptake values (SUV) of [68Ga]Ga-PentixaFor and IHC CXCR4 expression, by comparing the [68Ga]Ga-PentixaFor semi-quantitative data with the CXCR4 expression results of biopsied metastases at screening and at imaging evaluation performed within 3 to 9 months after first [68Ga]Ga-PentixaFor PET/CT if biopsy is performed., f) The tolerance of [68Ga]Ga-PentixaFor will be checked by measuring and monitoring vital signs for 60 minutes after [68Ga]Ga-PentixaFor administration. The patient will be informed that in the event of abnormal physical signs, occurring within 48 hours after [68Ga]Ga-PentixaFor administration, he (she) must inform the investigator for registration. The CTC-NCI Common Toxicity Criteria, version 5.0 reference will be used., g) Description of [68Ga]Ga-PentixaFor PET-CT data between patient inclusion time and imaging evaluation performed within 3 to 9 months after first [68Ga]Ga-PentixaFor PET/CT at the patient level will focus on the evolution of SUV., Exploratory )Plasma FLT3-Ligand dosage will be assessed at screening and at imaging evaluation performed within 3 to 9 months after first [68Ga]Ga-PentixaFor PET/CT.

Source: https://euclinicaltrials.eu/ctis-public/view/2024-517658-90-00